EU clinical trial 2023-507809-34-00: A Phase 1/2 Study of Linvoseltamab in Patients with Relapsed or Refractory Systemic Light Chain Amyloidosis
Protocol code: R5458-ONC-2274
Sponsor: Regeneron Pharmaceuticals Inc. (Pharmaceutical company). Phase: Phase I and Phase II (Integrated)- Other. Countries: Spain (ongoing, recruiting), Greece (ongoing, recruiting).
Therapeutic area(s): Diseases [C] - Neoplasms [C04]
Gender: Female, Male. Age: 18-64 years, 65+ years. Enrolment: 27.
Status: Ongoing, recruiting. Start date (EU): 2024-08-07. Decision date: 2024-06-03. Results received: No. Last updated: 2026-07-30.
Decision dates by country: GR: 2025-07-15, ES: 2024-06-03

Condition(s): Relapsed or Refractory Systemic Light Chain Amyloidosis
Product: Linvoseltamab, REGN88, Paracetamol 500mg Tablets, Dexamethasone 2mg Tablets, Linvoseltamab, Diphenhydramine Hydrochloride 25 mg Tablets, RoActemra 20 mg/mL concentrate for solution for infusion, Dexamethasone phosphate 4 mg/ml solution for injection/infusion

Primary endpoint: Phase 1: Incidence of dose-limiting toxicity (DLTs), Phase 2: Achievement of hematologic complete response (CR) as determined by the Independent Review Committee (IRC)
Endpoint(s): Achievement of hematologic CR, as determined by the IRC - Phase 1, Achievement of hematologic very good partial response (VGPR) or better response (CR + VGPR), as determined by the IRC, Achievement of overall hematologic response (PR or better), as determined by the IRC, Time to initial hematologic response, Time to best hematologic response, Duration of hematologic response (ie, best response, VGPR or better, overall response), as determined by the IRC, Hematologic progression-free survival (PFS), Incidence of death, Incidence of treatment-emergent adverse events (TEAEs), Severity of TEAEs, Incidence of serious adverse events (SAEs), Severity of SAEs, Incidence of adverse events of special interest (AESIs), Severity of AESIs, Achievement of overall hematologic response (PR or better), as determined by the IRC in full dose regimen 1 vs 2 - Phase 2, Incidence of TEAEs in full dose regimen 1 vs 2 - Phase 2, Severity of TEAEs in full dose regimen 1 vs 2 - Phase 2, Incidence of SAEs in full dose regimen 1 vs 2 - Phase 2, Severity of SAEs in full dose regimen 1 vs 2 - Phase 2, Incidence of AESIs in full dose regimen 1 vs 2 - Phase 2, Severity of AESIs in full dose regimen 1 vs 2 - Phase 2, Time from treatment initiation to hematologic disease progression as determined by the IRC, Time from treatment initiation to cardiac deterioration, as determined by the IRC, Time from treatment initiation to kidney deterioration as determined by the IRC, Time from treatment initiation to death as determined by the IRC, Time from initiation of treatment to date of death from any cause, Achievement of renal response in participants with renal involvement at baseline, as determined by IRC, Achievement of cardiac response in participants with cardiac involvement at baseline, as determined by IRC, Time to first renal response in participants with renal involvement at baseline, Time to first cardiac response in participants with cardiac involvement at baseline, Linvoseltamab concentration in serum over time, Incidence of anti-drug antibodies (ADAs) to linvoseltamab over time, Titers of ADAs to linvoseltamab over time

Source: https://euclinicaltrials.eu/ctis-public/view/2023-507809-34-00